EU clinical trial 2023-506091-27-00: A Phase 2, Multicenter, Double-Blind, Randomized, Placebo-controlled Trial, evaluating Safety, Tolerability, and Efficacy of Subcutaneous Doses of TransCon CNP Administered Once Weekly for 52 Weeks in Infants (0 to <2 years of age) with Achondroplasia followed by an Open Label Extension (OLE) period.
Protocol code: ASND0030
Sponsor: Ascendis Pharma Growth Disorders A/S (Pharmaceutical company). Phase: Therapeutic exploratory (Phase II). Countries: Norway (ongoing, recruiting), Denmark (ongoing, recruiting), Spain (ended), Ireland (ongoing, recruiting), Germany (ongoing, recruiting), Austria (ongoing, recruiting), Sweden (ongoing, recruiting), Italy (authorised, recruitment pending), France (ongoing, recruiting), Portugal (ongoing, recruiting), Finland (ongoing, recruiting).
Therapeutic area(s): Diseases [C] - Musculoskeletal Diseases [C05]
Gender: Female, Male. Age: 0-17 years. Enrolment: 55.
Start date (EU): 2024-09-19. Decision date: 2024-04-15. Results received: No. Last updated: 2026-07-28.
Decision dates by country: ES: 2024-04-17, FI: 2025-03-13, PT: 2024-11-25, AT: 2024-04-22, FR: 2024-04-19, IE: 2024-04-19, DK: 2024-04-15, DE: 2024-04-22, IT: 2024-04-17, NO: 2024-04-16, SE: 2024-04-19

Condition(s): Achondroplasia in Children and Adolescents
Product: TransCon CNP 3.9 mg CNP-38/vial, Navepegritide 2.8 mg CNP(89-126), Navepegritide 1.3 mg CNP(89-126), Placebo for TransCon CNP

Primary endpoint: Incidence of treatment emergent adverse events (TEAEs) over 52 weeks, including Grade ≥ 3 TEAEs; serious adverse events (SAEs); TEAEs leading to discontinuation; deaths due to TEAEs, and all deaths, Change from baseline to 52 weeks in length/height Z-score
Endpoint(s): Annualized growth velocity (AGV) (cm/year) at 52 weeks and 104 weeks, Change from baseline to 104 weeks in length/height Z-score, Change from baseline to 52 weeks and 104 weeks in Bayley Scales, motor and language scales (4th edition), Change from baseline to 52 weeks and 104 weeks in evaluation (X-ray) of long bones and angles in lower limbs (e.g., femur, tibia, fibula, and tibia/fibula and femur/tibia ratio, mechanical axis deviations), Change from baseline to 52 weeks and 104 weeks in evaluation of MRI of spine (e.g., spine interpedicular distance (IPD), spine pedicle width (PW), spinal cord volume, and ratio of area of spinal cord to spinal canal), Change from baseline to 52 weeks and 104 weeks in evaluation of MRI of foramen magnum (e.g., sagittal and transverse diameters, surface area (cm2 ) of foramen magnum, ratio of spinal cord to foramen magnum area, and Achondroplasia Foramen Magnum Score (AFMS)), Incidence of complications and manifestations of ACH, for example, breathing related sleep disorder, otitis media, hearing loss, musculoskeletal (MS) pain and MS deformities, ACH-related TEAEs reported by investigators

Source: https://euclinicaltrials.eu/ctis-public/view/2023-506091-27-00